EU clinical trial 2024-513516-99-00: Durability of protection after single immunisation with genetically attenuated Plasmodium falciparum ∆mei2 (GA2) sporozoites – a follow-up, controlled human malaria rechallenge study
Sponsor: Leids Universitair Medisch Centrum (LUMC) (Hospital/Clinic/Other health care facility). Phase: Phase I and Phase II (Integrated)- Other. Countries: Netherlands (ended).
Therapeutic area(s): Diseases [C] - Parasitic Diseases [C03]
Gender: Female, Male. Age: 18-64 years. Enrolment: 14.
Status: Ended. Start date (EU): 2024-10-28. End date (EU): 2025-09-17. Decision date: 2024-10-07. Results received: No. Last updated: 2024-10-07.

Condition(s): Falciparum malaria

Source: https://euclinicaltrials.eu/ctis-public/view/2024-513516-99-00